EU clinical trial 2023-506919-18-00: A randomised double-blind placebo-controlled clinical trial investigating the effect and safety of oral semaglutide in subjects with early Alzheimer´s disease (EVOKE)
Protocol code: NN6535-4730
Sponsor: Novo Nordisk A/S (Pharmaceutical company). Phase: Therapeutic confirmatory (Phase III). Countries: Italy (ended), Bulgaria (ended), Romania (ended), Portugal (ended), Hungary (ended), Ireland (ended), Spain (ended), Netherlands (ended), Greece (ended), Germany (ended), Austria (ended), Poland (ended), France (ended), Czechia (ended), Finland (ended), Denmark (ended), Belgium (ended), Slovakia (ended), Slovenia (ended), Norway (ended), Sweden (ended).
Therapeutic area(s): Diseases [C] - Nervous System Diseases [C10]
Gender: Female, Male. Age: 18-64 years, 65+ years. Enrolment: 873.
Status: Ended. Start date (EU): 2021-05-17. End date (EU): 2025-11-24. End date: 2026-01-30. Decision date: 2024-02-08. Results received: No. Last updated: 2026-02-06.
Decision dates by country: BE: 2024-02-15, SI: 2024-02-19, BG: 2024-03-18, ES: 2024-02-12, RO: 2024-02-19, SK: 2024-02-08, DE: 2024-02-13, NL: 2024-02-13, NO: 2024-02-08, SE: 2024-02-12, FI: 2024-02-09, CZ: 2024-02-13, AT: 2024-03-25, GR: 2024-03-22, FR: 2024-06-05, DK: 2024-02-09, IE: 2024-02-08, HU: 2024-02-09, PL: 2024-03-04, IT: 2024-02-12, PT: 2024-02-08

Condition(s): Mild cognitive impairment (MCI) or mild dementia, both of the Alzheimer’s type
Product: Rybelsus 7 mg tablets, Placebo (semaglutide) tablets, Rybelsus 3 mg tablets, Rybelsus 14 mg tablets

Primary endpoint: Change in the Clinical Dementia Rating – Sum of Boxes (CDR-SB) Score. From baseline (week 0) to week 104. Score on scale (0 to 18).
Endpoint(s): Change in the 24-item Alzheimer’s Disease Cooperative Study Activities of Daily Living Scale for MCI (ADCS-ADL-MCI) score. From baseline (week 0) to week 104. Score on scale (0 to 53)., Time to progression to CDR global score ≥1.0 among patients with CDR global score = 0.5 at baseline. From baseline (week 0) up to week 156b.

Source: https://euclinicaltrials.eu/ctis-public/view/2023-506919-18-00